EU clinical trial 2023-504165-23-00: Randomized double-blind trial to study the benefit of Colchicine in Patients with Acutely Decompensated Heart Failure
Protocol code: IMIB-CO-2020-01
Sponsor: Fundacion Para La Formacion E Investigacion Sanitaria De La Region De Murcia (Educational Institution). Phase: Therapeutic confirmatory (Phase III). Countries: Spain (ended), Italy (ended).
Therapeutic area(s): Diseases [C] - Cardiovascular Diseases [C14]
Gender: Female, Male. Age: 18-64 years, 65+ years. Enrolment: 302.
Status: Ended. Start date (EU): 2021-02-08. End date (EU): 2024-04-30. Decision date: 2023-03-03. Results received: Yes. Last updated: 2023-05-25.
Decision dates by country: ES: 2023-03-03, IT: 2023-05-19

Condition(s): Acute decompensated heart failure
Product: COLCHICINA SEID 0,5 mg comprimidos

Primary endpoint: Decreased NT-proBNP levels
Endpoint(s): Improvement of clinical stability, Mortality rate reduction, Total days of hospitalization

Source: https://euclinicaltrials.eu/ctis-public/view/2023-504165-23-00